EU clinical trial 2023-509811-98-00: HEROES: De-escalation of medical therapies in HER2-positive metastatic breast cancer in long-term persistent response and minimal residual disease undetectable in circulating tumor DNA
Protocol code: UC-BCG-2312
Sponsor: Unicancer (Hospital/Clinic/Other health care facility). Phase: Therapeutic exploratory (Phase II). Countries: France (ongoing, recruiting).
Therapeutic area(s): Diseases [C] - Neoplasms [C04]
Gender: Female, Male. Age: 18-64 years, 65+ years. Enrolment: 282.
Status: Ongoing, recruiting. Start date (EU): 2025-01-07. Decision date: 2024-10-17. Results received: No. Last updated: 2026-08-06.

Condition(s): Patients with HER2-positive locally advanced inoperable or metastatic breast cancer with disease controlled after 2 years of maintenance treatment with anti-HER2 targeted therapy
Product: TRASTUZUMAB, PERTUZUMAB, TRASTUZUMAB EMTANSINE, TRASTUZUMAB DERUXTECAN, TRASTUZUMAB, TRASTUZUMAB EMTANSINE, TRASTUZUMAB

Primary endpoint: The progression-free rate (PFR) defined by radiological, and/or molecular progression. The PFR is defined as the time from the date of registration to the date of the first documented event among radiological progressions (RECIST 1.1), molecular progressions defined by ctDNA+, or death due to any cause, whichever occurs first. Patients alive without any of these events will be censored.
Endpoint(s): Efficacy : PFS will be defined as the time from the date of registration to the date of the first documented cancer progression measured by RECIST 1.1 or death due to any cause, whichever occurs first. Patients alive without progression will be censored., Efficacy : The ctDNA dynamics is defined as changes in the level of ctDNA (from negative to positive) during the surveillance phase. Positivity rate is defined as the proportion of patients with positive ctDNA., Efficacy : OS will be defined as the time from the date of registration to the date of death due to any cause., Efficacy : Molecular response is defined as the percentage of patients who reached molecular remission (ctDNA clearance) 3 months after reintroduction of anti-HER2 treatment among patients with ctDNA positive without RECIST progression., Efficacy : Objective Response Rate (ORR), defined as the number of patients with at least a confirmed complete response (CR) or partial response (PR) to reintroduction of anti-HER2 treatment, among patients with RECIST progression during the surveillance phase, Efficacy : Duration of Response (Dor) is defined, among patients with RECIST progression during the surveillance phase, as the time from the onset of response after reintroduction of anti-HER2 treatment, to progression or death due to any cause, whichever occurs first., Quality of Life : QoL will be assessed using the EORTC QLQ-C30 and QLQ-BR45 questionnaire, Quality of life : Anxiety will be assessed by the STAI-state questionnaire, Quality of life : Decision regret will be assessed by the decision regret scale

Source: https://euclinicaltrials.eu/ctis-public/view/2023-509811-98-00